EU clinical trial 2024-518139-12-00: A randomized non-comparative phase II study of Maintenance therapy with OSE2101 plus FOLFIRI, or FOLFIRI after induction therapy with FOLFIRINOX in patients with locally advanced or metastatic Pancreatic ductal adenocarcinoma.
Protocol code: D17-01 PRODIGE 63
Sponsor: Association Gercor (Laboratory/Research/Testing facility). Phase: Therapeutic exploratory (Phase II). Countries: France (authorised, recruitment pending).
Therapeutic area(s): Diseases [C] - Digestive System Diseases [C06]
Gender: Female, Male. Age: 18-64 years, 65+ years. Enrolment: 106.
Status: Authorised, recruitment pending. Decision date: 2024-11-14. Results received: No. Last updated: 2024-11-14.

Condition(s): locally advanced or metastatic Pancreatic ductal adenocarcinoma
Product: ELVORINE 100 mg/10 mL, solution injectable, TEDOPI, FLUOROURACILE PFIZER 50 mg/mL, solution à diluer pour perfusion, IRINOTECAN VIATRIS 20 mg/ml, solution à diluer pour perfusion

Primary endpoint: Evaluable patients for OS rate at 12 months will be patients alive at 12 months and patients dead within 12 months; patients lost to follow-up before 12 months without confirmation of death will be non-evaluable. The OS is defined according to the DATECAN consensus as the time from randomization to death for any reason. In the absence of confirmation of death, survival time will be censored at the date of the last clinical assessment.
Endpoint(s): PFS by centralized review of CT-scan imaging., All grade and severe (grade 3-5) toxicities, according to the National Cancer Institute (NCI) Common Terminology Criteria for Adverse Events (CTCAE) v5.0, Response according to RECIST v1.1 77 (centralized review of CT-scan imaging), HRQoL assessed by the European Organization for Research and Treatment of Cancer (EORTC) QLQ-C30 questionnaire, Q-TWiST, Potential predictive biomarkers (blood and tumor tissue), Immune-related AEs (imAEs) according to sarcopenia

Source: https://euclinicaltrials.eu/ctis-public/view/2024-518139-12-00